EU clinical trial 2024-513867-19-00: DORA Trial: Phase III Trial of Docetaxel vs. Docetaxel and Radium-223 for Metastatic Castration-Resistant Prostate Cancer (mCRPC)
Protocol code: c16-174
Sponsor: Memorial Sloan Kettering Cancer Center (Hospital/Clinic/Other health care facility). Phase: Therapeutic confirmatory (Phase III). Countries: Netherlands (ongoing, recruitment ended), Spain (ongoing, recruitment ended).
Therapeutic area(s): Diseases [C] - Neoplasms [C04]
Gender: Male. Age: 18-64 years, 65+ years. Enrolment: 285.
Status: Ongoing, recruitment ended. Start date (EU): 2019-01-31. Decision date: 2024-10-25. Results received: No. Last updated: 2026-07-21.
Decision dates by country: ES: 2024-10-28, NL: 2024-10-25

Condition(s): metastatic Castration-Resistant Prostate Cancer (mCRPC)
Product: Xofigo 1100 kBq/mL solution for injection

Primary endpoint: The OS comparison between treatments will be evaluated at each interim analysis and the final analysis using the stratified logrank test. The stratification factors are: 1. Prior docetaxel for castration-sensitive disease (Yes or No) 2. Visceral disease (presence or absence)
Endpoint(s): Time to event endpoints will be analyzed using a stratified logrank test with the same stratification factors. Kaplan-Meier estimates of SSE-free survival and radiographic PFS will be computed. The cumulative incidence function will be used to compute probabilities for the time to first skeletal related event and the time to ALP progression. All time to event probability estimates will be calculated within treatment., Total ALP response will be compared between the treatment groups using a CMH test adjusting for the randomization strata, Time to maximum % post-therapy decrease in PSA will be summarized using descriptive statistics, Maximum % decrease in PSA will be summarized using descriptive statistics (e.g., mean, standard deviation, median, minimum, and maximum), Longitudinal kernel smoothing methods will be used to estimate the PSA, bone marker, BSI, CTC, and ctDNA trajectories over time. Joint modeling will used to evaluate these trajectories with respect to OS, PROs will include scores from the QOL questionnaires: FACT-P, BPI, and BFI. The QOLs will be administered at baseline, week 19, Safety Follow Up, and Follow Up visits every 3 months for 1 year from last dose of either study drug. The scorespecific area under the curve (with respect to time) will be derived for each subject and these area-under-curve (AUCs) will be compared between treatments., The number and percentage of febrile neutropenia in subjects treated with docetaxel plus Radium-223, The percentage of treatment discontinuation in subjects who are on their fourth line of therapy will be calculated by treatment arm and total

Source: https://euclinicaltrials.eu/ctis-public/view/2024-513867-19-00